EU clinical trial 2025-521616-19-00: Pneumococcal booster vaccine responsiveness to PCV20 in persons of 78-84 years of age
Protocol code: IIV-720
Sponsor: Rijksinstituut voor Volksgezondheid en Milieu (RIVM) (Hospital/Clinic/Other health care facility). Phase: Therapeutic use (Phase IV). Countries: Netherlands (ongoing, recruitment ended).
Therapeutic area(s): Diseases [C] - Bacterial Infections and Mycoses [C01]
Gender: Female, Male. Age: 65+ years. Enrolment: 120.
Status: Ongoing, recruitment ended. Start date (EU): 2025-08-11. Decision date: 2025-07-01. Results received: No. Last updated: 2025-08-07.

Condition(s): Healthy adults receiving a profylactic vaccine to prevent pneumococcal infection
Product: Prevenar 20 suspension for injection in pre-filled syringe Pneumococcal polysaccharide conjugate vaccine (20-valent, adsorbed)

Primary endpoint: PCV20 specific serum IgG, IgM and IgA concentrations pre-PCV20 and 1 month post-PCV20 vaccination
Endpoint(s): PCV20 specific serum IgG, IgM and IgA pre-PCV20, 1 month and 11 months post-PCV20 vaccination, IgG, IgM and IgA in serum one month post-PCV20 and one month post PPSV23 vaccination, PCV20 specific IgG and IgA concentrations pre-, 1 month and 11 months post-PCV20 vaccination in mucosal lining fluid

Source: https://euclinicaltrials.eu/ctis-public/view/2025-521616-19-00